EU clinical trial 2023-509583-22-00: A Phase 2, Single-Arm, Open-Label Study with Dostarlimab Monotherapy in Participants with Untreated Stage II/III dMMR/MSI-H Locally Advanced Rectal Cancer
Protocol code: 219369
Sponsor: Glaxosmithkline Research & Development Limited (Pharmaceutical company). Phase: Therapeutic exploratory (Phase II). Countries: Spain (ongoing, recruitment ended), France (ongoing, recruiting), Italy (ongoing, recruitment ended), Germany (ongoing, recruiting), Netherlands (ongoing, recruitment ended).
Therapeutic area(s): Diseases [C] - Neoplasms [C04]
Gender: Female, Male. Age: 18-64 years, 65+ years. Enrolment: 51.
Start date (EU): 2023-03-14. Decision date: 2024-03-15. Results received: No. Last updated: 2026-01-02.
Decision dates by country: IT: 2024-03-18, DE: 2024-03-19, ES: 2024-03-19, NL: 2024-03-15, FR: 2024-03-18

Condition(s): Neoplasms, Rectal
Product: JEMPERLI 500 mg concentrate for solution for infusion

Primary endpoint: cCR12 as assessed by ICR, defined as maintenance of cCR for 12 months. The 12-month period starts from the first disease assessment after last dose of study intervention that demonstrates cCR by ICR.
Endpoint(s): cCR24 as assessed by ICR, defined as maintenance of cCR for 24 months. The 24-month period starts from the first disease assessment after last dose of study intervention that demonstrates cCR by ICR., cCR36 as assessed by ICR, defined as maintenance of cCR for 36 months. The 36-month period starts from the first disease assessment after last dose of study intervention that demonstrates cCR by ICR, EFS3 as assessed by investigator assessment, defined as remaining alive and free of 1) disease progression precluding surgery, 2) local recurrence, and 3) distant recurrence, as assessed by investigator at 3 years from the first dose of study intervention.

Source: https://euclinicaltrials.eu/ctis-public/view/2023-509583-22-00